EU clinical trial 2023-509248-86-00: A phase 2/3, multicenter, randomized, double-blind study to evaluate the efficacy, safety, pharmacokinetics and pharmacodynamics of oral ozanimod (RPC1063) in pediatric subjects with moderately to severely active ulcerative colitis with an inadequate response to conventional therapy.
Protocol code: IM047-001
Sponsor: Bristol-Myers Squibb Services Unlimited Company (Pharmaceutical company). Phase: Phase II and Phase III (Integrated). Countries: France (ongoing, recruiting), Germany (ongoing, recruiting), Spain (ended), Belgium (authorised, recruiting), Poland (ongoing, recruiting).
Therapeutic area(s): Diseases [C] - Digestive System Diseases [C06]
Gender: Female, Male. Age: 0-17 years. Enrolment: 62.
Start date (EU): 2022-03-11. Decision date: 2024-03-15. Results received: No. Last updated: 2026-07-22.
Decision dates by country: ES: 2024-03-18, FR: 2024-03-19, BE: 2024-03-27, PL: 2024-03-25, DE: 2024-03-15

Condition(s): Moderately to Severely Active Ulcerative Colitis
Product: Ozanimod, Ozanimod, Ozanimod

Primary endpoint: Proportion of subjects who achieve clinical remission, defined as all the following: • Mayo Endoscopy Subscore (MES) ≤ 1 • Rectal Bleeding Subscore (RBS) = 0 • Stool Frequency Subscore (SFS) ≤ 1, with a decrease of ≥ 1 point from Baseline SFS, Proportion of subjects who achieve histological remission, defined as the following: - Geboes index score < 2.0 - Robarts Histopathology Index (RHI) ≤ 3, with subscores of 0 for both lamina propria neutrophils and neutrophils in the epithelium, Early Discontinuation: Starting at Week 5 or later if either one of the following criteria are met at 2 consecutive visits that are at least 2 weeks apart: - Partial Mayo score is ≥ 7 and is the same or worse than baseline, AND rectal bleeding and stool frequency are not improved from baseline - Partial Mayo score is 6 and worse than baseline, AND rectal bleeding and stool frequency are not improved from baseline
Endpoint(s): Proportion of subjects who achieve clinical response defined as all the following: • Decrease from Baseline in the 3-component Mayo score of at least 2 points and at least 35% • Decrease in RBS of at least 1 point OR absolute RBS ≤ 1, Proportion of subjects who achieve clinical remission defined as all the following: • MES ≤ 1 • RBS = 0 • SFS ≤ 1, with a decrease of ≥1 point from Baseline SFS, Proportion of subjects who achieve symptomatic improvement of UC, defined as all the following: • RBS = 0 • SFS ≤ 1 • Decrease in SFS of ≥ 1 from Baseline, Proportion of subjects who achieve endoscopic improvement, defined as MES ≤ 1, Proportion of subjects who achieve corticosteroid-free remission at Week 52, defined as all the following: • Did not receive steroids for ≥ 12 weeks prior to Week 52 • Achieved clinical remission defined by the 3-component Mayo score, Secondary – Safety and Tolerability Number and proportion of subjects experiencing AEs, SAEs, AEs leading to discontinuation from treatment, and AEs of interest (AEIs), Secondary - Pharmacokinetics Steady state systemic exposure of ozanimod and CC112273, Secondary – Pharmacodynamics Absolute and percent change from baseline in ALC

Source: https://euclinicaltrials.eu/ctis-public/view/2023-509248-86-00